EU clinical trial 2025-521209-42-00: A biomarker enrichment trial of anti-EGFR agents in patients with advanced colorectal cancer (aCRC) with wild-type RAS and right primary tumour location (right-PTL) - ARIEL-ENGIC trial
Protocol code: ARIEL-ENGIC
Sponsor: Fondazione GONO G.I. (Patient organisation/association). Phase: Therapeutic use (Phase IV). Countries: Italy (authorised, recruitment pending), Germany (authorised, recruitment pending), Spain (authorised, recruitment pending).
Therapeutic area(s): Diseases [C] - Neoplasms [C04]
Gender: Female, Male. Age: 18-64 years, 65+ years. Enrolment: 120.
Status: Authorised, recruitment pending. Decision date: 2025-10-06. Results received: No. Last updated: 2026-05-26.
Decision dates by country: DE: 2025-10-07, IT: 2025-10-06, ES: 2025-10-06

Condition(s): advanced colorectal cancer with wild-type RAS and right primary tumour location (right-PTL)
Product: CAPECITABINE, BEVACIZUMAB, OXALIPLATIN, CETUXIMAB, FOLINIC ACID, IRINOTECAN, FLUOROURACIL

Primary endpoint: Early tumour shrinkage (ETS) defined as the percentage of patients, relative to the total of the enrolled subjects, achieving a ≥30% decrease in the sum of maximum diameters (SMD) of RECIST target lesions at week 8 compared to the SMD recorded at baseline., Overall survival (OS) defined as the time from randomization to the date of death due to any cause. For patients still alive at the time of analysis, the OS time will be censored on the last date the patients were known to be alive
Endpoint(s): Depth of response (DpR) defined as the maximum tumour shrinkage of RECIST target lesions at the nadir, in the absence of new lesions or progression of non-target lesions, when compared with baseline, assessed at 16 weeks from start of treatment., Objective Response Rate (ORR) defined as the percentage of patients, relative to the total of enrolled subjects, achieving a complete (CR) or partial (PR) response, according to RECIST 1.1 criteria, during the treatment. The determination of clinical response will be based on investigator reported measurements. Responses will be evaluated every 8 weeks, Progression-free survival defined as the time from randomization to the first documentation of objective disease progression or death due to any cause, whichever occurs first. PFS will be censored on the date of the last evaluable on study tumor assessment documenting absence of progressive disease for patients who are alive, on study and progression free at the time of the analysis., Patient-reported QOL, measured using the EORTC QLQ-C30 and EORTC QLQ-CR29 disease specific module with additional items to cover anti-EGFR symptomatic toxicity using the EORTC-QLQ item library. This will be assessed at baseline, 8 weeks, 16 weeks, 12- and 24-months post-randomisation, Overall Toxicity Rate defined as the percentage of patients, relative to the total of enrolled subjects, experiencing any adverse event, according to National Cancer Institute Common Toxicity Criteria (version 5.0), during the treatment., Toxicity Rate defined as the percentage of patients, relative to the total of enrolled subjects, experiencing a specific adverse event of grade 3/4, according to National Cancer Institute Common Toxicity Criteria (version 5.0), during the treatment, Assessment of prognostic and predictive ability of other candidate biomarkers with regard to participant outcomes and anti-EGFR efficacy, including negative hyperselection by gene alterations in circulating tumour DNA (ctDNA) related to primary resistance to anti-EGFR therapy

Source: https://euclinicaltrials.eu/ctis-public/view/2025-521209-42-00